EU clinical trial 2023-508688-54-00: An open-label first-in-human single ascending dose study to explore the safety, tolerability and efficacy of subretinal administration of CPK850 gene therapy in patients with retinitis pigmentosa caused by mutations in the RLBP1 gene
Protocol code: CCPK850X2202
Sponsor: Novartis Pharma AG (Pharmaceutical company). Phase: Phase I and Phase II (Integrated)- First administration to humans. Countries: Sweden (ended).
Therapeutic area(s): Diseases [C] - Eye Diseases [C11]
Gender: Female, Male. Age: 18-64 years, 65+ years. Enrolment: 21.
Status: Ended. Start date (EU): 2018-08-22. End date (EU): 2026-05-12. End date: 2026-05-13. Decision date: 2024-01-19. Results received: No. Last updated: 2026-05-08.

Condition(s): Retinitis pigmentosa caused by biallelic mutations in the RLBP1 gene
Product: CPK850

Primary endpoint: Number of participants with adverse events (AEs), serious adverse events (SAEs) and deaths, Number of responders in dark adaptation (A patient is considered a responder if sensitivity recovery values at 1-hour post-bleach are observed to be outside of the patient's prediction interval at ≥2 consecutive posttreatment visits within one year after treatment.)
Endpoint(s): Number of patients with recovery of the cone system, Number of patients with improvement in rod function in the treated eye vs the untreated eye, Change from screening/baseline in Visual field perimetry mean deviation, Change from screening/baseline in Total contrast sensitivity score, Change from screening/baseline in Light-adapted microperimetry sensitivity, Change from screening/baseline in Reading speed, Change from screening/baseline in the local electrical activity of the retina, Change from screening/baseline in eye dominance, Change from screening/baseline in mobility test scores, Change from screening/baseline in the National Eye Institute -Visual function questionnaire 25 (NEI-VFQ 25) composite score, Change from screening/baseline in the low luminance questionnaire (LLQ) responses, Change from screening/baseline in the Functional vision questionnaire (FVQ), as available, Change from screening/baseline in the electrical activity of the retina

Source: https://euclinicaltrials.eu/ctis-public/view/2023-508688-54-00